EU clinical trial 2024-514089-37-00: GLO-Surgery: Indocyanine Green and near infrared fLuorescence in paediatric Oncology surgery
Protocol code: RG_23-026
Sponsor: The University Of Birmingham (Educational Institution). Phase: Therapeutic exploratory (Phase II). Countries: Netherlands (ongoing, recruiting).
Therapeutic area(s): Diseases [C] - Neoplasms [C04]
Gender: Female, Male. Age: 0-17 years, 18-64 years, 65+ years. Enrolment: 30.
Status: Ongoing, recruiting. Start date (EU): 2026-06-16. Decision date: 2026-04-30. Results received: No. Last updated: 2026-04-30.

Condition(s): Patients with pulmonary metastasis from any primary tumour, or who have an abdominal or thoracic Rhabdomyosarcoma (RMS), Non-rhabdomyosarcomatous soft tissue sarcoma (NRSTS), Neuroblastoma (NBL) or a Malignant Germ cell tumour (mGCT) where complete resection by keyhole or open surgery is planned, and/or patients with a renal tumour or para-testicular RMS (ptRMS) requiring lymph node dissection
Product: Verdye 5 mg/ml powder for solution for injection

Primary endpoint: Cohorts 2 and 3: Total number of nodes sampled
Endpoint(s): Cohorts 2 and 3: Location of nodes sampled and results of histopathological assessment of lymph nodes, Incidence and severity of Adverse Events (AEs) related to the dye as defined by National Cancer Institute Common Terminology Criteria for Adverse Events (CTCAE) v5, Efficacy of dosing measured by fluorescence level of the tumour tissue and as compared to non-tumour tissue (4 category ordinal scale), Surgical complications: Incidence of individual and overall incidence. Surgical complication status up to discharge following index surgical procedure as defined by Clavien-Dindo scale, Surgical satisfaction ratings (9 category ordinal scale)

Source: https://euclinicaltrials.eu/ctis-public/view/2024-514089-37-00